EU clinical trial 2024-514362-39-00: LOADEX: PILOT AND PHASE 2 STUDY OF THE EFFICACY OF A TREATMENT PROTOCOL WITH DEXAMETHASONE IMPLANT LOADING DOSE IN PATIENTS WITH DIABETIC MACULAR EDEMA
Protocol code: 69HCL19_0588
Sponsor: Hospices Civils De Lyon (Hospital/Clinic/Other health care facility). Phase: Therapeutic exploratory (Phase II). Countries: France (ongoing, recruitment ended).
Therapeutic area(s): Diseases [C] - Eye Diseases [C11]
Gender: Female, Male. Age: 18-64 years, 65+ years. Enrolment: 100.
Status: Ongoing, recruitment ended. Start date (EU): 2019-12-05. Decision date: 2024-08-27. Results received: No. Last updated: 2026-01-12.

Condition(s): Diabetic macular oedema
Product: OZURDEX 700 micrograms intravitreal implant in applicator

Primary endpoint: Difference between the highest value of Best Corrected Visual Acuity (BCVA) observed during follow-up to 52 weeks and the BCVA observed at inclusion (best observed improvement). Corrected visual acuity will be measured as the number of letters on the Early Treatment Diabetic Retinopathy Study (ETDRS) scale at an initial distance of 4 meters.
Endpoint(s): Describe the time required to reach the highest MAVC value during the first 52 weeks, as well as the number of injections., Description of VA by : oDifference between the highest value of BCVA observed up to M18 and up to M24 and the value at inclusion. Corrected VA measured on the ETDRS scale; o VA value at each visit (monthly for the 1st year) and area under the curve between inclusion and S52 and between inclusion and M24; o At S12,S24,S36,S52,M18 and M24, as well as for the highest CVAM observed in 52 weeks: proportion of patients by CVAM change category (cf protocole), Total number of injections performed per patient at S52 and M24., Patient discomfort related to the intravitreal implant, measured by a visual analog scale (VAS between 0 and 10) at each visit between S0 and S52., At S12,S24,S36,S52,M18 and M24; as well as for the visit at which the best improvement over 52 weeks is observed: Variation in CMT and central foveolar thickness and qualitative analysis of each OCT (from a central section of the fovea: presence of interruptions of the ellipsoid, outer limiting membrane, intraretinal cysts or logettes, presence of disorganized inner retinal layers, subretinal fluid, foveolar depression, epiretinal membrane, vitreo-macular traction and macular exudates)., Proportion of patients with resolution of macular oedema (defined as absence of intraretinal fluid 6 months or more after the last injection) at S52 and M24., At S12, S24, S36, S52, M18 and M24, the number and percentage of patients with each grade of diabetic retinopathy according to the Staging DRSS will be calculated: improvement (gain of 2 levels or gain of 3 levels), no change, or worsening (loss of 2 levels or loss of 3 levels); between inclusion and S12, S24, S36, S52, M18 and M24, according to a centralised review on colour fundus photographs including at least the 7 ETDRS fields i.e. 30 degrees., At S12, S24, S36, S52, M18 and M24: qualitative and quantitative analysis of diabetic vascularisation and non-perfusion zones on OCT-angiography (size of capillary non-perfusion zones, size of central avascular zone, presence of macular ischaemia) according to a centralised reading, At each visit: condition of lens implant and posterior chamber determined by biomicroscopy with fundus., Change in intraocular pressure between inclusion and S52, and between inclusion and M24, and proportion of patients using hypotonising therapy for 24 months., Adverse events observed throughout the study: o Frequency of ocular prognostic adverse events: see protocol o Incidence of non-ocular life-threatening adverse events: see protocol o Incidence of systemic adverse events: see protocol

Source: https://euclinicaltrials.eu/ctis-public/view/2024-514362-39-00